EU clinical trial 2023-509004-15-00: An Open-Label, Multi-Drug, Biomarker-Directed, Multi-Centre Phase II Umbrella Study in Patients with Non-Small Cell Lung Cancer, who Progressed on an anti-PD-1/PD-L1 Containing Therapy (HUDSON).
Protocol code: D6185C00001
Sponsor: AstraZeneca AB (Pharmaceutical company). Phase: Phase II and Phase III (Integrated). Countries: Spain (ended), Germany (ongoing, recruitment ended), France (ongoing, recruitment ended), Austria (ongoing, recruitment ended).
Therapeutic area(s): Diseases [C] - Neoplasms [C04]
Gender: Female, Male. Age: 18-64 years, 65+ years. Enrolment: 172.
Start date (EU): 2018-02-20. Decision date: 2024-08-09. Results received: No. Last updated: 2025-06-05.
Decision dates by country: ES: 2024-08-09, FR: 2024-08-13, AT: 2024-08-12, DE: 2024-08-12

Condition(s): Patients with non-small cell lung cancer (NSCLC).
Product: INFLIXIMAB, DS-8201a, AZD6738, MYCOPHENOLATE MOFETIL, IMFINZI 50 mg/mL concentrate for solution for infusion.

Primary endpoint: Endpoint based on Response Evaluation Criteria in Solid Tumours (RECIST 1.1) Objective response rate (ORR)
Endpoint(s): Overall Survival (OS)., Endpoints based on RECIST 1.1 including: Disease control rate (DCR), Endpoints based on RECIST 1.1 including: Best percentage change in tumour size, Endpoints based on RECIST 1.1 including: Duration of response (DoR), Endpoints based on RECIST 1.1 including: Progression free survival (PFS).

Source: https://euclinicaltrials.eu/ctis-public/view/2023-509004-15-00